EU clinical trial 2024-519272-96-00: SAFETY AND EFFICACY OF A 10-DAY COURSE OF REMDESIVIR TO PREVENT SEVERE COVID-19 IN ASYMPTOMATIC OR PAUCISYMPTOMATIC SARS-COV-2-POSITIVE KIDNEY TRANSPLANT RECIPIENTS: A SINGLE-ARM PROOF-OF-CONCEPT INTERVENTIONAL TRIAL
Protocol code: COVIDKIDNEY
Sponsor: Fundacion Fls De Lucha Contra El Sida Las Enfermedades Infecciosas Y La Promocion De La Salud Y La C (Patient organisation/association). Phase: Therapeutic exploratory (Phase II). Countries: Spain (ongoing, recruiting).
Therapeutic area(s): Diseases [C] - Virus Diseases [C02]
Gender: Female, Male. Age: 18-64 years, 65+ years. Enrolment: 15.
Status: Ongoing, recruiting. Start date (EU): 2025-08-07. Decision date: 2025-06-30. Results received: No. Last updated: 2025-06-30.

Condition(s): COVID-10 infection
Product: Veklury 100 mg powder for concentrate for solution for infusion

Primary endpoint: Number and proportion of participants who develop severe COVID-19 following kidney transplantation up to 28 days and 90 days post-transplant. Severe SARS-CoV-2 will be defined as: Hypoxemia (O2 sat <94%), one or more compatible respiratory symptoms (fever, dyspnea, increased respiratory frequency > 22, cough) AND new radiologic infiltrates compatible with COVID-19 in a chest X Ray, chest CT or ultrasound.
Endpoint(s): Number of deaths at days 28 and 90 post-transplantation (global and attributable to COVID-19), -Time (days) to resolution of all targeted symptoms through Day 28 and Day 90 -Time (days) to alleviation of symptoms through Day 28 and Day 90. -Duration of targeted COVID-19 symptoms. -Proportion of participants requiring extension of the hospitalization beyond POD10. -Number of days in hospital and intensive care unit (ICU) stay -Proportion of participants with symptomatic rebound through day 28. IMV through day 28., - Number and proportion of participants with negative nasopharyngeal SARS-CoV-2 PCR, and median CT values if positive, at POD 0 (time of diagnosis), POD5, POD10, POD14, POD21, and POD28. - Whole genome sequencing of SARS-CoV-2 to evaluate emergence of substitutions associated with resistance to remdesivir in participants who have a positive SARS-CoV-2 PCR and CT values below or equal to 25., - Number and % of participants with stage 2 or 3 AKI through day 28, or RRTdependence at day 28 and 90. -Number and proportion of patients that present a proven-biopsy showing acute humoral or cellular rejection at D28 and D90 posttransplant. -Difference in the number, proportion, and days of dialysis per patient needed at D7, D28 and D90 compared to a local historical cohort of kidney transplants performed between 2023 and 2024., Incidence of SAEs and AEs leading to drug discontinuation.- Number and proportion of any treatment-emergent hepatic AE (Elevation of any grade in ALT or AST levels, prothrombin time or INR, or blood bilirubin), number and proportion of severe liver failures. - Number of patients that develop hypersensitivity or infusion-related reactions

Source: https://euclinicaltrials.eu/ctis-public/view/2024-519272-96-00